EU clinical trial 2024-514004-14-00: Study of Safety, Tolerability, Pharmacodynamics and Pharmacokinetics of NIO752 in Early Alzheimer's Disease Participants
Protocol code: NIO752B12201
Sponsor: Novartis Pharma AG (Pharmaceutical company). Phase: Human Pharmacology (Phase I)- Other. Countries: Spain (ongoing, recruitment ended), Finland (ended), France (ongoing, recruitment ended), Sweden (ended).
Therapeutic area(s): Diseases [C] - Nervous System Diseases [C10]
Gender: Female, Male. Age: 18-64 years, 65+ years. Enrolment: 37.
Start date (EU): 2023-02-23. Decision date: 2024-08-02. Results received: No. Last updated: 2026-01-12.
Decision dates by country: FI: 2024-08-02, SE: 2024-08-02, FR: 2024-08-07, ES: 2024-08-06

Condition(s): Alzheimer’s Disease

Source: https://euclinicaltrials.eu/ctis-public/view/2024-514004-14-00